EU clinical trial 2024-519237-34-00: An Adaptive Phase II/III, Double-Blind, Randomized, Placebo-controlled, Two-Part, Dose-Finding, Multi-center Study of the Safety and Efficacy of NaBen®, a D-Amino Acid Oxidase Inhibitor, as an Add-on Therapy with Clozapine, for Residual Symptoms of Refractory Schizophrenia in Adults
Protocol code: SNR-05
Sponsor: Syneurx International (Taiwan) Corp. (Pharmaceutical company). Phase: Phase II and Phase III (Integrated). Countries: Poland (ongoing, recruiting).
Therapeutic area(s): Psychiatry and Psychology [F] - Mental Disorders [F03]
Gender: Female, Male. Age: 18-64 years. Enrolment: 50.
Status: Ongoing, recruiting. Start date (EU): 2019-11-26. Decision date: 2025-01-28. Results received: No. Last updated: 2025-01-28.

Condition(s): Treatment for Refractory Schizophrenia in Adults
Product: Placebo for NaBen, NaBen F.C.T.II

Primary endpoint: Mean change from baseline in Positive and Negative Syndrome Scale (PANSS) total score after 8 weeks of randomized treatment
Endpoint(s): Percent change from baseline in PANSS total score after 8 weeks of treatment, Percentage of subjects with 20% or more reduction from baseline in PANSS total score after 8 weeks of treatment, Percent change in PANSS sub-scales and Marder PANSS factor scores, Percent change in Personal and Social Performance (PSP) scale, Percent change in Schizophrenia Quality of Life Scale (SQLS), Percent change in Clinical Global Impression-Severity (CGI-S) and -improvement (CGI-I), Percent change in Hamilton Depression Rating Scale (HDRS), Serum pharmacokinetic evaluations

Source: https://euclinicaltrials.eu/ctis-public/view/2024-519237-34-00